EU clinical trial 2023-505438-85-00: Multi-center, double-blind, randomized, placebo-controlled, parallel-group study to evaluate the efficacy and safety of self-administered subcutaneous selatogrel for prevention of all-cause death and treatment of acute myocardial infarction in subjects with a recent history of acute myocardial infarction
Protocol code: ID-076A301
Sponsor: Viatris Innovation GmbH (Pharmaceutical company). Phase: Therapeutic confirmatory (Phase III). Countries: Austria (ongoing, recruiting), Netherlands (ongoing, recruiting), Denmark (ongoing, recruiting), Poland (ongoing, recruiting), Romania (ongoing, recruiting), Slovakia (ongoing, recruiting), Italy (ongoing, recruiting), Bulgaria (ongoing, recruiting), Lithuania (ongoing, recruiting), France (ongoing, recruiting), Hungary (ongoing, recruiting), Finland (ongoing, recruiting), Belgium (ongoing, recruiting), Spain (ongoing, recruiting), Czechia (ongoing, recruiting), Norway (ongoing, recruiting), Estonia (ongoing, recruiting), Greece (ongoing, recruiting), Portugal (ongoing, recruiting), Germany (ongoing, recruiting), Croatia (ongoing, recruiting), Latvia (ongoing, recruiting), Sweden (ongoing, recruiting).
Therapeutic area(s): Diseases [C] - Cardiovascular Diseases [C14]
Gender: Female, Male. Age: 18-64 years, 65+ years. Enrolment: 14825.
Status: Ongoing, recruiting. Start date (EU): 2022-01-12. Decision date: 2024-01-26. Results received: No. Last updated: 2026-08-04.
Decision dates by country: BG: 2024-01-26, RO: 2024-02-20, AT: 2024-03-18, BE: 2024-02-05, CZ: 2024-01-30, DK: 2024-01-26, EE: 2024-01-31, FI: 2024-01-29, FR: 2024-02-16, DE: 2024-05-24, GR: 2024-03-11, HU: 2024-01-26, IT: 2024-02-23, LT: 2024-02-14, NL: 2024-01-26, NO: 2024-01-26, PT: 2024-01-26, PL: 2024-02-05, ES: 2024-01-26, SK: 2024-01-26, HR: 2026-02-27, LV: 2026-02-26, SE: 2026-02-12

Condition(s): Acute myocardial infarction (AMI)
Product: Selatogrel solution matching placebo, Selatogrel solution

Primary endpoint: Efficacy: Occurrence of death or non-fatal AMI after any study treatment self-administration. The outcome will be ranked from most to least severe: 1. Death (all causes)* 2. AMI with compromised electro-hemodynamics** 3. STEMI** 4 .High-risk NSTEMI** 5. NSTEMI with peak cardiac troponin > 10 × upper limit of normal** 6. None of the above within *7/**2 days after each treatment administration Only the worst outcome will be retained as the primary endpoint., Safety: Occurrence of type 3 or 5 treatment-emergent bleeding events according to the Bleeding Academic Research Consortium (BARC) definition, within 2 days after study treatment administration.
Endpoint(s): Occurrence of death, non-fatal AMI, hospitalization or unplanned emergency department visit for heart failure, within 30 days after any treatment administration (composite endpoint).

Source: https://euclinicaltrials.eu/ctis-public/view/2023-505438-85-00